EU clinical trial 2024-513186-39-01: Phase 2 INSPIRE trial: Ipilimumab with Nivolumab in molecular-selected patients with castration-resistant prostate cancer
Sponsor: Stichting Radboud universitair medisch centrum (Hospital/Clinic/Other health care facility). Phase: Therapeutic exploratory (Phase II). Countries: Netherlands (ended).
Therapeutic area(s): Diseases [C] - Male Urogenital Diseases [C12]
Gender: Male. Age: 18-64 years. Enrolment: 77.
Status: Ended. Start date (EU): 2025-02-01. End date (EU): 2025-12-18. Decision date: 2025-01-29. Results received: Yes. Last updated: 2025-01-29.

Condition(s): castration-resistant prostate cancer
Product: YERVOY 5 mg/ml concentrate for solution for infusion, OPDIVO 10 mg/mL concentrate for solution for infusion.

Primary endpoint: disease control rate (DCR) of >6mo; this includes SD, PR or CR by best ORR in evaluable patients, all lasting longer than 6 months
Endpoint(s): Safety (first secondary endpoint): - Percentage of Grade 3/4 and 5 treatment-related AE's Efficacy (second secondary endpoint): - Best objective response rate (ORR) per RECIST1 .1 criteria - Biochemica! response rate at week 13 and maxi mal PSA decline according to Prostate Cancer Working Group 3 criteria (PCWG3) - Radiographic progression free survival per irRECIST1 .1 immune-related response criteria

Source: https://euclinicaltrials.eu/ctis-public/view/2024-513186-39-01